EU clinical trial 2024-512747-23-00: A Phase 3, Double-blind, Randomized, Placebo-Controlled, Multicenter Study Evaluating the Efficacy and Safety of Mitapivat in Subjects With Transfusion-Dependent Alpha or Beta Thalassemia (ENERGIZE-T)
Protocol code: AG348-C-018
Sponsor: Agios Pharmaceuticals Inc. (Pharmaceutical company). Phase: Therapeutic confirmatory (Phase III). Countries: France (ongoing, recruitment ended), Netherlands (ongoing, recruitment ended), Italy (ongoing, recruitment ended), Germany (ongoing, recruitment ended), Denmark (ongoing, recruitment ended), Bulgaria (ongoing, recruitment ended), Greece (ongoing, recruitment ended), Spain (ongoing, recruitment ended).
Therapeutic area(s): Diseases [C] - Hemic and Lymphatic Diseases [C15]
Gender: Female, Male. Age: 18-64 years, 65+ years. Enrolment: 128.
Status: Ongoing, recruitment ended. Start date (EU): 2024-07-30. Decision date: 2024-07-30. Results received: No. Last updated: 2026-06-16.
Decision dates by country: GR: 2024-08-22, BG: 2024-08-05, DK: 2024-08-05, DE: 2024-08-01, FR: 2024-08-02, NL: 2024-07-30, ES: 2024-08-01, IT: 2024-09-16

Condition(s): Transfusion-Dependent Alpha- or Beta-Thalassemia
Product: Placebo for Mitapivat, MITAPIVAT

Primary endpoint: Transfusion reduction response (TRR), defined as a ≥50% reduction in transfused red blood cell (RBC) units with a reduction of ≥2 units of transfused RBCs in any consecutive 12-week period through Week 48 compared with baseline

Source: https://euclinicaltrials.eu/ctis-public/view/2024-512747-23-00